EU clinical trial 2022-502861-78-00: A study in healthy women to test whether BI 1358894 influences the amount of a contraceptive in the blood
Protocol code: 1402-0019
Sponsor: Boehringer Ingelheim International GmbH (Pharmaceutical company). Phase: Human Pharmacology (Phase I)- Other. Countries: Germany (ended).
Therapeutic area(s): Psychiatry and Psychology [F] - Mental Disorders [F03]
Gender: Female. Age: 18-64 years. Enrolment: 32.
Status: Ended. Start date (EU): 2023-09-08. End date (EU): 2024-02-08. Decision date: 2023-05-26. Results received: No. Last updated: 2023-09-29.

Condition(s): Pharmacokinetic trial

Source: https://euclinicaltrials.eu/ctis-public/view/2022-502861-78-00